EU clinical trial 2022-501082-52-00: Long-Term Follow-up: Phase I/II clinical study to evaluate the safety and efficacy of the infusion of RP-L102
Protocol code: RP-L102-0221-LTFU
Sponsor: Rocket Pharmaceuticals Inc. (Pharmaceutical company). Phase: Phase I and Phase II (Integrated)- Other. Countries: Spain (ongoing, recruiting).
Therapeutic area(s): Diseases [C] - Congenital, Hereditary, and Neonatal Diseases and Abnormalities [C16]
Gender: Female, Male. Age: 0-17 years, 18-64 years. Enrolment: 3.
Status: Ongoing, recruiting. Start date (EU): 2023-03-01. Decision date: 2022-10-07. Results received: No. Last updated: 2025-05-08.

Condition(s): Fanconi anemia subtype A (FA-A)
Product: Fancalen

Primary endpoint: To evaluate long-term safety following infusion of hematopoietic cells transduced with the therapeutic LV, To determine long-term persistence of the therapeutic LV (provirus) in hematopoietic cells in the bone marrow (BM) and blood, and to evaluate potential correlations between provirus/transgene persistence and hematologic stability (absence of BMF or hematologic malignancy)., To determine long-term clonality patterns beyond the 3-year follow-up stipulated in the RP-L102 parent studies (RP-L102-0418, RP-L102-0319, RP-L102-0118)., To evaluate, when relevant, RCL in serum and peripheral blood cells (this will not be considered relevant for subjects in whom no evidence of RCL was identified during the initial year following investigational autologous cell infusion)., To determine the long-term stability and normalization of blood counts in patients subsequent to infusion of autologous FANCA-corrected hematopoietic cells., To determine the phenotypic correction of BM and PB cells (as evaluated by resistance to DNA-damaging agents) in long-term follow-up after gene therapy., To enable preliminary assessment of the incidence of hematologic malignancies (including AML/MDS) and solid organ tumors (including squamous cell carcinoma of the head and neck); occurrence of these events will be evaluated in the context of the underlying rates of these malignancies in FA patient populations (both those who have not undergone allogeneic stem cell transplant and FA patients post-HSCT).

Source: https://euclinicaltrials.eu/ctis-public/view/2022-501082-52-00